EU clinical trial 2023-503783-16-00: Effect of itraconazole on the pharmacokinetics of a single oral dose of BI 1815368 in healthy male subjects (an open-label, two-period fixed-sequence design study)
Protocol code: 1485-0003
Sponsor: Boehringer Ingelheim International GmbH (Industry). Phase: Human Pharmacology (Phase I)- Other. Countries: Germany (ended).
Therapeutic area(s): Diseases [C] - Eye Diseases [C11]
Gender: Male. Age: 18-64 years. Enrolment: 14.
Status: Ended. Start date (EU): 2023-08-02. End date (EU): 2023-10-24. Decision date: 2023-06-22. Results received: Yes. Last updated: 2023-06-22.

Condition(s): Healthy
Product: Sempera Liquid 10 mg/ml Lösung zum Einnehmen

Primary endpoint: AUC0-∞ (area under the concentration-time curve of the analyte in plasma over the time interval from 0 extrapolated to infinity), Cmax (maximum measured concentration of the analyte in plasma)
Endpoint(s): AUC0-tz (area under the concentration-time curve of the analyte in plasma over the time interval from 0 to the last quantifiable data point)

Source: https://euclinicaltrials.eu/ctis-public/view/2023-503783-16-00